EU clinical trial 2024-518422-32-01: Programmed death ligand 1 (PD-L1) PET imaging in patients with (Diffuse) Large B-cell Lymphoma who are treated with CD19-directed CAR T-cell therapy: a pilot study
Sponsor: Universitair Medisch Centrum Groningen (Hospital/Clinic/Other health care facility). Phase: Phase I and Phase II (Integrated)- Other. Countries: Netherlands (ended).
Therapeutic area(s): Diseases [C] - Hemic and Lymphatic Diseases [C15]
Gender: Female, Male. Age: 18-64 years, 65+ years. Enrolment: 20.
Status: Ended. Start date (EU): 2026-05-20. End date (EU): 2026-05-20. Decision date: 2024-11-20. Results received: No. Last updated: 2024-11-20.

Condition(s): (Diffuse) Large B-cell Lymphoma
Product: Tecentriq 1 200 mg concentrate for solution for infusion

Primary endpoint: to study the expression of PD-L1 in normal tissue and lymphoma lesions before CD19- directed CAR T-cell therapy in LBCL patients by 89Zr-atezolizumab PET/CT imaging and to correlate pretreatment 89Zr-atezolizumab uptake to response to CD19-directed CAR T-cell therapy and thereby identify clinically relevant PD-L1 expression. Heterogeneity of 89Zr-atezolizumab uptake will be evaluated by measuring standardized uptake value (SUV) on the 89Zr-atezolizumab PET/CT scan, To study whether the amount of 89Zr-atezolizumab uptake, measured by the intensity of 89Zr-atezolizumab PET/CT imaging (SUV), can be used to differentiate between lymphoma activity and treatment-related inflammatory reaction (histiocytic/sarcoidlike reaction) in patients with an end-of-treatment 18F-FDG-positive PET/CT signal
Endpoint(s): To correlate the pretreatment 89Zr-atezolizumab distribution to CAR T-cell peak expansion and persistence, To correlate the pretreatment 89Zr-atezolizumab uptake to CAR T-cell therapy related grade 1-5 adverse events (cytokine release syndrome (CRS) and immune effector cell associated neurotoxicity syndrome (ICANS))., To correlate tumor 89Zr-atezolizumab uptake with tumor and immune cell PD-L1 expression as assessed by immunohistochemistry on a fresh contemporaneous tumor biopsy, To compare the 89Zr-atezolizumab distribution in irradiated versus non-irradiated lymphoma lesions in patients who require radiotherapy as a bridging strategy prior to CAR T-cell infusion. If possible, these results will be compared to tumor and immune cell PD-L1 expression as assessed by immunohistochemistry on a fresh contemporaneous tumor biopsy of an irradiated lymphoma lesion, To determine the incidence of a treatment-related inflammatory signal on 18F-FDGPET/CT scan (histiocytic/sarcoid-like reaction) after CAR T-cell therapy

Source: https://euclinicaltrials.eu/ctis-public/view/2024-518422-32-01